EU clinical trial 2024-514998-21-00: OSAGE : Phase I-II study chemoradiation in elderly patients with oesophagus cancer
Protocol code: N/2014/68
Sponsor: Centre Hospitalier Regional Universitaire (Hospital/Clinic/Other health care facility). Phase: Phase I and Phase II (Integrated)- Other. Countries: France (ongoing, recruiting).
Therapeutic area(s): Diseases [C] - Otorhinolaryngologic Diseases [C09]
Gender: Female, Male. Age: 65+ years. Enrolment: 54.
Status: Ongoing, recruiting. Start date (EU): 2024-07-10. Decision date: 2024-07-10. Results received: No. Last updated: 2024-07-10.

Condition(s): cancer de l'oesophage
Product: Carboplatinum Hikma Farmacêutica 150 mg Solution à diluer pour perfusion, PACLITAXEL

Primary endpoint: l’absence : d’œsophagite de grade 3 rebelle à un traitement antalgique de palier 3 ou/et d’infection avec température ≥ 38°5 quel que soit la porte d’entrée, rebelle après un traitement antibiotique IV de plus de 48h pendant le traitement et 1 mois après la fin du traitement,
Endpoint(s): - L’observance au traitement, - Toxicités aigües en cours de traitement, - Evaluation de la qualité de vie relative à la santé (EORTC QLQ-C30, ELD14), - Survie sans progression, - Survie globale

Source: https://euclinicaltrials.eu/ctis-public/view/2024-514998-21-00